EU clinical trial 2023-509227-41-00: ATTENUATION – A multicenter randomized phase II study of the efficacy and safety de-escalation versus standard adjuvant chemotherapy in patients with low risk localized gastroesophageal adenocarcinoma (study PRODIGE/FRENCH 39)
Protocol code: ET23-350
Sponsor: Centre Leon Berard (Hospital/Clinic/Other health care facility). Phase: Therapeutic exploratory (Phase II). Countries: France (ended).
Therapeutic area(s): Diseases [C] - Neoplasms [C04]; Diseases [C] - Digestive System Diseases [C06]
Gender: Female, Male. Age: 18-64 years, 65+ years. Enrolment: 120.
Status: Ended. End date (EU): 2026-06-02. Decision date: 2024-07-23. Results received: No. Last updated: 2024-07-23.

Condition(s): Low risk of disease recurrence, defined by the following criteria: - Absence of lymph node involvement (ypN0), assessed on a min. of 15 lymph nodes and, - Either ypT0-2 ( all TRG grade) or ypT3 (with TRG 1a-b according to Becker classification or TRG1-2 according to Mandard’s classification),, Completed both pre-operative chemotherapy with a fluoropyrimidine-platinum containing regimen (FLOT 4 cycles) and microscopically complete (R0) resection prior to randomization, non-metastatic (M0) gastric, esophageal or gastroesophageal junction adenocarcinoma
Product: DOCETAXEL, OXALIPLATIN, CALCIUM FOLINATE, FLUOROURACIL

Primary endpoint: The 3-year Overall Survival (OS) rate, described as the proportion of patients still alive 3 years after the date of randomization
Endpoint(s): • Overall survival (OS), • Disease-Free Survival (DFS), • Pattern and rate of relapse, • Tolerability profile, • Health-related quality of life and nutritional status, and correlation of these parameters with survival outcomes, A cost-effectiveness analysis of a de-escalation strategy compared to the standard postoperative chemotherapy, A Human and Social Sciences sub-study will be conducted in both study arms to assess if emotional competences will be predictive of HRQoL (Global Health Status dimension of the QLQ-C30) and/or supportive care needs mediated by anxio/depressive symptoms

Source: https://euclinicaltrials.eu/ctis-public/view/2023-509227-41-00